EU clinical trial 2023-506183-13-00: A Phase IIa, Randomized, Double-Blind, Placebo-Controlled, Multiple Dose, Multicenter, Parallel-Group Study to Investigate the Safety, Tolerability, and the Effect of RO7269162 on Amyloid and Non-Amyloid Disease-Related Biomarkers following Daily Oral Administration in Participants at Risk for or at the Prodromal Stage of Alzheimer’s Disease
Protocol code: BP44745
Sponsor: F. Hoffmann-La Roche AG (Pharmaceutical company). Phase: Therapeutic exploratory (Phase II). Countries: Denmark (ongoing, recruitment ended), Spain (ongoing, recruitment ended), Germany (ongoing, recruitment ended), France (ongoing, recruitment ended), Italy (ongoing, recruitment ended), Poland (ongoing, recruitment ended).
Therapeutic area(s): Diseases [C] - Nervous System Diseases [C10]
Gender: Female, Male. Age: 18-64 years, 65+ years. Enrolment: 186.
Status: Ongoing, recruitment ended. Start date (EU): 2024-03-29. Decision date: 2024-03-11. Results received: No. Last updated: 2026-07-03.
Decision dates by country: ES: 2024-03-12, DK: 2024-03-11, PL: 2024-03-15, FR: 2024-03-18, IT: 2024-03-13, DE: 2024-03-12

Condition(s): Alzheimer’s Disease
Product: RO7269162, RO7269162, FLORBETABEN (18F), Placebo RO7269162, FLUTEMETAMOL (18F), RO7269162

Primary endpoint: 1. Nature, incidence, severity, and outcome of AEs, 2. Changes from baseline in vital signs, ECG parameters, Columbia-Suicide Severity Rating Scale (C-SSRS) and safety laboratory findings, 3. Change from baseline in brain amyloid load, as measured by amyloid PET scan
Endpoint(s): 1. Change from baseline in Aβ37, Aβ38, Aβ40 and Aβ42 in CSF and Aβ40 and Aβ42 in plasma, 2. Plasma concentrations of RO7269162 (and its metabolite[s] as appropriate), 3. CSF concentrations of RO7269162 (and its metabolite[s] as appropriate)

Source: https://euclinicaltrials.eu/ctis-public/view/2023-506183-13-00